EU clinical trial 2025-524103-69-00: Phase II/III randomized controlled open-label trial to evaluate the efficacy and safety of personalized tissue engineered veins in patients with chronic venous insufficiency
Protocol code: TECVI-2
Sponsor: VeriGraft AB (Pharmaceutical company). Phase: Phase II and Phase III (Integrated). Countries: Spain (authorised, recruiting).
Therapeutic area(s): Diseases [C] - Cardiovascular Diseases [C14]
Gender: Female, Male. Age: 18-64 years, 65+ years. Enrolment: 60.
Status: Authorised, recruiting. Start date (EU): 2026-06-10. Decision date: 2026-04-27. Results received: No. Last updated: 2026-05-26.

Condition(s): Chronic Venous Insufficiency
Product: Personalized Tissue Engineered Vein

Primary endpoint: Valve competency at 6 months post P-TEV implantation vs control (using Color Duplex Ultrasound to measure reflux), rVCSS score reduction at 6 months post implantation vs control (using the rVCCS)
Endpoint(s): Valve competency at 1, 3, 6, 12 months post-implantation vs pre-implantation (Color Duplex Ultrasound), Change in hemodynamics / reflux time at 1, 3, 6, 12 months post-implantation vs pre-implantation (Color Duplex Ultrasound), Relief of clinical signs and symptoms at 1, 3, 6, 12 months post-implantation vs pre-implantation (Ankle + calf circumference, VEINES-SYM, rVCSS, CEAP/Villalta score)), Ulcer healing at 1, 3, 6, 12 months post-implantation vs pre-implantation (ulcer number, location, area and depth), Vein disease related QoL (VEINES-QOL) and general health-related QoL (SF-36/6D) at 1, 3, 6, 12 months post-implantation vs pre-implantation, Product related and surgical procedure related adverse events (Safety)

Source: https://euclinicaltrials.eu/ctis-public/view/2025-524103-69-00